EU clinical trial 2023-504595-26-00: A Multicenter, Open-Label, Dose-Finding, Phase 2 Study Evaluating THIO Sequenced with Cemiplimab (LIBTAYO®) in Subjects with Advanced Non-Small Cell Lung Cancer (NSCLC)
Protocol code: THIO-101
Sponsor: Maia Biotechnology Inc. (Pharmaceutical company). Phase: Therapeutic exploratory (Phase II). Countries: Bulgaria (ended), Hungary (ongoing, recruiting), Poland (ongoing, recruiting), Romania (ongoing, recruiting).
Therapeutic area(s): Diseases [C] - Neoplasms [C04]
Gender: Female, Male. Age: 18-64 years, 65+ years. Enrolment: 222.
Start date (EU): 2023-05-22. Decision date: 2024-06-26. Results received: No. Last updated: 2026-05-07.
Decision dates by country: BG: 2024-07-12, RO: 2025-06-23, HU: 2024-06-26, PL: 2024-07-18

Condition(s): Non-Small Cell Lung Cancer
Product: LIBTAYO 350 mg concentrate for solution for infusion., THIO

Primary endpoint: Part A: Incidence of DLTs., Part C: ORR, defined as the proportion of subjects with either a CR or PR, as assessed by the investigator based on RECIST v1.1 (Safety endpoints: see below), Part D: ORR, defined as the proportion of subjects with a confirmed CR or PR, as assessed by BICR based on RECIST v1.1, Part A and Part B: Incidence of TEAEs, and SAEs overall, by severity, by relationship to THIO and/or cemiplimab, and those that led to discontinuation of THIO and cemiplimab and/or withdrawal from study, Part A and Part B: • ORR, defined as the proportion of subjects with either a CR or PR, as assessed by the investigator based on RECIST v1.1 • DCR defined as the proportion of subjects with CR, PR, or SD, as assessed by the investigator based on RECIST v1.1
Endpoint(s): Part A and Part B: DoR, PFS, and OS, Part C: • DoR, DCR, PFS, as assessed by the Investigator based on RECIST v1.1 •OS, Part D: • DoR, DCR, PFS, as assessed by BICR based on RECIST v1.1 •ORR, DoR, DCR, PFS, as assessed by the Investigator based on RECIST v1.1 OS

Source: https://euclinicaltrials.eu/ctis-public/view/2023-504595-26-00